EU clinical trial 2025-522348-42-00: LAMP-COVID: Locating Amyloid-containing Microclots with total-body PET in post-COVID syndrome
Sponsor: Amsterdam UMC Stichting (Patient organisation/association). Phase: Phase I and Phase II (Integrated)- Other. Countries: Netherlands (authorised, recruiting).
Therapeutic area(s): Diseases [C] - Virus Diseases [C02]
Gender: Female, Male. Age: 18-64 years. Enrolment: 65.
Status: Authorised, recruiting. Start date (EU): 2026-07-05. Decision date: 2026-05-07. Results received: No. Last updated: 2026-05-07.

Condition(s): post-COVID syndrome (long COVID)
Product: FLUTEMETAMOL (18F)

Primary endpoint: Quantitative measures of [18F]Flutemetamol binding throughout the body of participants, expressed in parameters such as volume of distribution (VT) or non displaceable binding potential (BPND) (depending on the most suitable kinetic model per region or tissue of interest (ROI)).
Endpoint(s): Amyloid-containing microclot load (size and quantity) in blood., Questionnaire scores on presence and severity of (post-COVID) symptoms, MRI-derived parameters on brain structure and function.

Source: https://euclinicaltrials.eu/ctis-public/view/2025-522348-42-00